EU clinical trial 2023-506289-29-00: eHealth Based treatment of AdolescenT obesiTy with Low energy diet and sEmaglutide (eBATTLE Obesity)
Sponsor: Vestfold Hospital Trust (Hospital/Clinic/Other health care facility). Phase: Therapeutic use (Phase IV). Countries: Norway (ongoing, recruiting).
Therapeutic area(s): Diseases [C] - Nutritional and Metabolic Diseases [C18]
Gender: Female, Male. Age: 0-17 years. Enrolment: 220.
Status: Ongoing, recruiting. Start date (EU): 2025-02-28. Decision date: 2023-11-16. Results received: No. Last updated: 2025-01-24.

Condition(s): Obesity
Product: Semaglutide placebo, Semaglutide B 3.0 mg/mL PDS290 or semaglutide placebo

Primary endpoint: Percentage change in BMI (Time frame: From week 8 to week 60)
Endpoint(s): The main secondary endpoints include the number and severity of adverse events, physical activity, sleep, psychiatric symptoms, eating disorder symptoms, and health-related quality of life. In addition, changes in fat mass, fat-free mass, blood glucose, blood lipids, blood pressure, and other cardiometabolic risk factors will be compared between the treatment groups.

Source: https://euclinicaltrials.eu/ctis-public/view/2023-506289-29-00